EU clinical trial 2024-511814-20-00: A Phase Ib Safety, Pharmacokinetics and Pharmacodynamics Study of TU7710 in Patients with Haemophilia A or B
Protocol code: TUB4PI-02
Sponsor: Tiumbio Co. Ltd. (Pharmaceutical company). Phase: Human Pharmacology (Phase I)- Other. Countries: Italy (authorised, recruitment pending), Spain (authorised, recruiting), Bulgaria (authorised, recruiting), Romania (ended).
Therapeutic area(s): Diseases [C] - Hemic and Lymphatic Diseases [C15]
Gender: Male. Age: 18-64 years, 65+ years. Enrolment: 21.
Start date (EU): 2024-12-10. Decision date: 2024-07-08. Results received: No. Last updated: 2026-08-05.
Decision dates by country: RO: 2025-02-25, ES: 2024-07-08, BG: 2025-03-18, IT: 2024-07-12

Condition(s): Hemophilia

Source: https://euclinicaltrials.eu/ctis-public/view/2024-511814-20-00